EU clinical trial 2023-507141-28-00: A Phase 1/2, open label, first-in-human, dose escalation and expansion study for the evaluation of safety, pharmacokinetics, pharmacodynamics, and anti-tumor activity of SAR445877 administered as monotherapy or in combination with other anticancer therapies in adults with advanced solid tumors
Protocol code: TCD17620
Sponsor: Sanofi-Aventis Recherche & Developpement (Pharmaceutical company). Phase: Phase I and Phase II (Integrated)- First administration to humans. Countries: Netherlands (ongoing, recruiting), Spain (ongoing, recruiting).
Therapeutic area(s): Diseases [C] - Neoplasms [C04]
Gender: Female, Male. Age: 18-64 years, 65+ years. Enrolment: 147.
Status: Ongoing, recruiting. Start date (EU): 2025-01-29. Decision date: 2024-10-23. Results received: No. Last updated: 2026-07-23.
Decision dates by country: ES: 2024-10-23, NL: 2024-10-31

Condition(s): Solid tumor
Product: Zirabev 25 mg/ml concentrate for solution for infusion, Erbitux 5 mg/mL solution for infusion, SAR445877, Zirabev 25 mg/ml concentrate for solution for infusion

Primary endpoint: Dose escalation part 1A and Japan Cohort F Presence of dose-limiting toxicities (DLTs) in Cycles 1 and 2, Dose escalation and Japan Cohort F: Percentage of participants experiencing treatment-emergent adverse events (TEAEs), Dose expansion/optimization: Objective response rate (ORR), Dose escalation part 1B Presence of dose-limiting toxicities (DLTs) in Cycles 1 to 3
Endpoint(s): Dose escalation and Japan Cohort F Objective response rate (ORR), Dose escalation, expansion/optimization and Japan Cohort F Duration of response (DoR), Dose escalation, expansion/optimization and Japan Cohort F Assessment of SAR445877 Cmax, Dose escalation, expansion/optimization and Japan Cohort F Assessment of SAR445877 AUCtau, Dose escalation, expansion/optimization and Japan Cohort F Assessment of SAR445877 Tmax, Dose escalation, expansion/optimization in Combination Assessment of combined therapies Ctrough, Dose escalation, expansion/optimization and Japan Cohort F Percentage of participants with presence of anti-drug antibodies (ADAs) against SAR445877, Dose expansion/optimization Time to response, Dose expansion/optimization Clinical Benefit Rate, Dose expansion/optimization Progression-free survival, Dose expansion/optimization Number of participants with Adverse events (AE), Dose expansion/optimization Overall survival, Dose escalation, expansion/optimization Percentage of participants with presence of anti-drug antibodies (ADAs) against ADG126

Source: https://euclinicaltrials.eu/ctis-public/view/2023-507141-28-00